EU clinical trial 2022-501863-41-00: A Phase 3, Multicenter, Randomized, Open-label Study Evaluating Efficacy of Sotorasib Platinum Doublet Combination Versus Pembrolizumab Platinum Doublet Combination as a Front line Therapy in Subjects With Stage IV or Advanced Stage IIIB/C Nonsquamous Non small Cell Lung Cancers, Negative for PD L1, and Positive for KRAS p.G12C (CodeBreaK 202)
Protocol code: 20190341
Sponsor: Amgen Inc. (Pharmaceutical company). Phase: Therapeutic confirmatory (Phase III). Countries: Poland (ongoing, recruiting), Greece (ongoing, recruiting), Belgium (ongoing, recruiting), Portugal (ongoing, recruiting), Hungary (ongoing, recruiting), Netherlands (ongoing, recruiting), Bulgaria (ongoing, recruiting), Latvia (ended), France (ongoing, recruiting), Italy (ongoing, recruiting), Spain (ongoing, recruiting), Romania (ongoing, recruiting), Germany (ongoing, recruiting), Denmark (ongoing, recruiting), Sweden (ongoing, recruiting), Czechia (ongoing, recruiting), Austria (ongoing, recruiting).
Therapeutic area(s): Diseases [C] - Neoplasms [C04]
Gender: Female, Male. Age: 18-64 years, 65+ years. Enrolment: 367.
Start date (EU): 2023-11-13. Decision date: 2023-10-20. Results received: No. Last updated: 2026-07-22.
Decision dates by country: LV: 2023-10-27, IT: 2023-10-25, SE: 2023-10-25, BG: 2023-10-30, CZ: 2023-10-25, PL: 2023-10-30, BE: 2023-10-23, DE: 2023-10-24, PT: 2024-01-19, RO: 2023-11-06, AT: 2023-10-30, FR: 2023-10-20, DK: 2023-10-20, NL: 2023-10-30, GR: 2023-10-20, ES: 2023-10-27, HU: 2023-10-25

Condition(s): Subjects With Stage IV or Advanced Stage IIIB/C Nonsquamous Non–Small Cell Lung Cancers, Negative for PD-L1, and Positive for KRAS p.G12C
Product: CARBOPLATIN, PEMBROLIZUMAB, HYDROXOCOBALAMIN, PEMETREXED, FOLIC ACID, SOTORASIB, DEXAMETHASONE

Primary endpoint: PFS is defined as the length of time from randomization (when the participants are designated to receive either sotorasib or pembrolizumab with chemotherapy) until the disease has progressed (gotten worse) or resulted in death, whichever occurs first. Progression will be based on an independent assessment of disease response per a set of predefined criteria (Response Evaluation Criteria in Solid Tumors [RECIST] v1.1) by reviewers with no knowledge of the participant’s treatment assignment.
Endpoint(s): Objective response is defined as the best overall response of complete response (CR, disappearance of all signs of NSCLC in the body) or partial response (PR, decrease in the amount of NSCLC in the body) to study treatment based on RECIST v1.1, per BICR. A confirmatory scan after 4 weeks of initial response is required for CR and PR., OS is defined as the duration of time from randomization until death due to any cause.

Source: https://euclinicaltrials.eu/ctis-public/view/2022-501863-41-00